EU clinical trial 2024-510964-21-00: Single-arm dose-escalation Phase 1/2 study of olaptesed pegol (NOX-A12) in combination with irradiation in inoperable or partially resected first-line glioblastoma patients with unmethylated MGMT promoter with a multiple-arm expansion group
Protocol code: SNOXA12C401
Sponsor: TME Pharma AG (Pharmaceutical company). Phase: Phase I and Phase II (Integrated)- Other. Countries: Germany (ongoing, recruiting).
Therapeutic area(s): Diseases [C] - Neoplasms [C04]
Gender: Female, Male. Age: 18-64 years, 65+ years. Enrolment: 136.
Status: Ongoing, recruiting. Start date (EU): 2019-09-12. Decision date: 2024-04-05. Results received: No. Last updated: 2026-06-09.

Condition(s): Glioblastoma
Product: KEYTRUDA 25 mg/mL concentrate for solution for infusion, Temodal 100 mg hard capsules, Temodal 5 mg hard capsules, NOX-A12, Temodal 20 mg hard capsules, Avastin 25 mg/ml concentrate for solution for infusion., Temodal 100 mg hard capsules, Temodal 20 mg hard capsules, Temodal 250 mg hard capsules, Temodal 250 mg hard capsules, Temodal 180 mg hard capsules, Temodal 180 mg hard capsules, Temodal 140 mg hard capsules, Temodal 5 mg hard capsules, MVASI 25 mg/mL concentrate for solution for infusion, Temodal 140 mg hard capsules

Primary endpoint: • Safety (adverse events)
Endpoint(s): Dose Escalation Cohorts und Expansion Group Arms A-C:, • PFS at 6 months (PFS-6), • Median progression-free survival (mPFS), • Median overall survival (mOS), • Tumor vascularization as per vascular MRI scans at baseline and 2, 4, and 6 months, • Topography of recurrence, • Determination of maximum tolerated dose (MTD), • Definition of recommended Phase 2 dose (RP2D), • Olaptesed plasma levels at steady state, • NANO assessment, • Quality of Life, Expansion Group Arms D-H:, • PFS at 6 months (PFS-6), • Median progression-free survival (mPFS), • Median overall survival (mOS), • Landmark overall survival at 18 months (OS18), • Overall response rate (ORR), • Olaptesed plasma levels at steady state, • Quality of Life

Source: https://euclinicaltrials.eu/ctis-public/view/2024-510964-21-00